EU clinical trial 2024-512704-20-00: A randomized study to investigate the efficacy and safety of the tumor-targeting human antibody-cytokine fusion protein L19TNF in previously treated patients with advanced stage or metastatic soft-tissue sarcoma
Protocol code: PH-L19TNFSARC-03/18
Sponsor: Philogen S.p.A. (Pharmaceutical company). Phase: Therapeutic exploratory (Phase II). Countries: Germany (ongoing, recruitment ended), Italy (ongoing, recruitment ended), Poland (ended), Spain (ongoing, recruitment ended), France (ongoing, recruitment ended).
Therapeutic area(s): Diseases [C] - Neoplasms [C04]
Gender: Female, Male. Age: 18-64 years, 65+ years. Enrolment: 98.
Start date (EU): 2020-06-22. Decision date: 2024-05-01. Results received: No. Last updated: 2026-06-12.
Decision dates by country: FR: 2024-05-06, DE: 2024-05-01, IT: 2024-05-03, PL: 2024-05-06, ES: 2024-05-06

Condition(s): Unresectable and/or metastatic soft-tissue sarcoma after failure of at least two prior systemic therapy regimens.
Product: Fibromun, Dacarbazine medac 1000 mg, powder for solution for infusion

Primary endpoint: The following primary efficacy endpoint will be considered: − Progression-free survival (PFS) in according to RECIST v.1.1
Endpoint(s): The following key secondary endpoint will be considered: − Overall survival (OS)

Source: https://euclinicaltrials.eu/ctis-public/view/2024-512704-20-00